EU clinical trial 2025-520946-31-00: Phase I clinical trial evaluating TG4070 in patients with non-small cell lung cancer
Protocol code: TG4070.01
Sponsor: Transgene (Pharmaceutical company). Phase: Human Pharmacology (Phase I)- First administration to humans. Countries: France (authorised, recruitment pending).
Therapeutic area(s): Diseases [C] - Neoplasms [C04]
Gender: Female, Male. Age: 18-64 years, 65+ years. Enrolment: 40.
Status: Authorised, recruitment pending. Decision date: 2025-07-15. Results received: No. Last updated: 2026-04-27.

Condition(s): Non-Small Cell Lung Cancer

Source: https://euclinicaltrials.eu/ctis-public/view/2025-520946-31-00